EU clinical trial 2024-511472-32-00: I6T-MC-AMAY - A Phase 3, Multicenter, Randomized Clinical Study to Evaluate Mirikizumab in Pediatric Crohn’s Disease
Protocol code: I6T-MC-AMAY
Sponsor: Eli Lilly & Co. (Pharmaceutical company). Phase: Therapeutic confirmatory (Phase III). Countries: Italy (ongoing, recruiting), Netherlands (ongoing, recruiting), Portugal (ongoing, recruiting), France (ended), Spain (ongoing, recruiting), Poland (ongoing, recruiting), Norway (ongoing, recruiting), Belgium (ongoing, recruiting), Austria (ongoing, recruiting).
Therapeutic area(s): Diseases [C] - Digestive System Diseases [C06]
Gender: Female, Male. Age: 0-17 years. Enrolment: 30.
Start date (EU): 2024-03-12. Decision date: 2024-07-31. Results received: No. Last updated: 2026-05-27.
Decision dates by country: FR: 2024-08-06, BE: 2024-08-01, NO: 2024-08-05, PL: 2024-08-04, NL: 2024-07-31, PT: 2024-08-28, AT: 2024-08-05, ES: 2024-08-08, IT: 2024-08-19

Condition(s): Crohn's Disease
Product: Mirikizumab, Mirikizumab, Mirikizumab

Primary endpoint: Percentage of Participants with Clinical Response by Pediatric Crohn's Disease Activity Index (PCDAI) at Week 12 and Endoscopic Response by Simple Endoscopic Score for CD (SES-CD) at Week 52 [ Time Frame: Baseline to Week 52 ] Clinical response based on PCDAI, and endoscopic response based on SES-CD, Percentage of Participants with a Clinical Response by PCDAI at Week 12 and Clinical Remission by PCDAI at Week 52 [ Time Frame: Baseline to Week 52 ] Clinical response based on PCDAI, and clinical remission based on PCDAI

Source: https://euclinicaltrials.eu/ctis-public/view/2024-511472-32-00